EU clinical trial 2024-516711-24-00: A PHASE 1/2 STUDY OF ONCOBAX®-AK ADMINISTERED IN COMBINATION WITH IMMUNOTHERAPY TO PATIENTS WITH ADVANCED SOLID TUMORS
Protocol code: EV-2101
Sponsor: Everimmune (Pharmaceutical company). Phase: Phase I and Phase II (Integrated)- First administration to humans. Countries: Belgium (ended), France (ended).
Therapeutic area(s): Diseases [C] - Neoplasms [C04]
Gender: Female, Male. Age: 18-64 years, 65+ years. Enrolment: 128.
Status: Ended. Start date (EU): 2022-10-18. End date (EU): 2026-04-09. Decision date: 2024-10-04. Results received: No. Last updated: 2025-07-10.
Decision dates by country: FR: 2024-10-09, BE: 2024-10-04

Condition(s): Non-Small Cell Lung Cancer (NSCLC), Renal Cell Carcinoma (RCC)
Product: Oncobax®-AK, LIBTAYO 350 mg concentrate for solution for infusion., OPDIVO 10 mg/mL concentrate for solution for infusion., YERVOY 5 mg/ml concentrate for solution for infusion, Tecentriq 1 200 mg concentrate for solution for infusion, KEYTRUDA 25 mg/mL concentrate for solution for infusion

Primary endpoint: Phase 1: - AEs, TEAEs, related TEAEs, SAEs, DLTs per NCI CTCAE version 5.0. - Dose reductions and interruptions. Phase 2: - ORR per iRECIST
Endpoint(s): Phase 2: - PFS9, OS12, DOR. - AEs, TEAEs, related TEAEs, SAEs, DLTs, per NCI-CTCAE version 5.0. - Dose reductions and interruptions

Source: https://euclinicaltrials.eu/ctis-public/view/2024-516711-24-00